EU clinical trial 2026-526096-31-00: A Randomized Study in Healthy Participants to Identify the Optimal Subcutaneous Injection Strategy for COR-1167
Protocol code: COR1167-102
Sponsor: Corteria Pharmaceuticals (Pharmaceutical company). Phase: Human Pharmacology (Phase I)- Other. Countries: Netherlands (ongoing, recruiting).
Therapeutic area(s): Diseases [C] - Cardiovascular Diseases [C14]
Gender: Female, Male. Age: 18-64 years, 65+ years. Enrolment: 20.
Status: Ongoing, recruiting. Start date (EU): 2026-05-20. Decision date: 2026-05-13. Results received: No. Last updated: 2026-05-13.

Condition(s): Chronic Heart Failure

Source: https://euclinicaltrials.eu/ctis-public/view/2026-526096-31-00